EU clinical trial 2024-518914-18-00: A Phase 2, Open-Label Extension Trial to Evaluate the Long-term Safety and Tolerability of Oral Zasocitinib (TAK-279) in Participants with Moderately to Severely Active Ulcerative Colitis and Moderately to Severely Active Crohn’s Disease
Protocol code: TAK-279-IBD-2001
Sponsor: Takeda Development Center Americas Inc. (Pharmaceutical company). Phase: Therapeutic exploratory (Phase II). Countries: Czechia (ongoing, recruiting), Norway (authorised, recruiting), Slovakia (ongoing, recruiting), Italy (ongoing, recruiting), Belgium (authorised, recruitment pending), Netherlands (ongoing, recruiting), Denmark (authorised, recruitment pending), Poland (ongoing, recruiting), Romania (ongoing, recruiting), Germany (authorised, recruiting), Hungary (ongoing, recruiting), Greece (authorised, recruitment pending), France (authorised, recruitment pending), Bulgaria (authorised, recruitment pending).
Therapeutic area(s): Diseases [C] - Digestive System Diseases [C06]
Gender: Female, Male. Age: 18-64 years, 65+ years. Enrolment: 113.
Start date (EU): 2025-08-27. Decision date: 2025-05-07. Results received: No. Last updated: 2026-06-01.
Decision dates by country: RO: 2025-05-19, SK: 2025-05-12, NL: 2025-08-06, FR: 2025-05-09, BE: 2025-05-08, GR: 2025-05-07, DE: 2025-05-07, IT: 2025-05-13, NO: 2025-05-13, DK: 2025-05-07, CZ: 2025-05-12, PL: 2025-05-19, BG: 2026-06-01, HU: 2025-05-13

Condition(s): Moderate to Severely Active Ulcerative Colitis & Moderate to Severely Active Crohn's Disease
Product: ZASOCITINIB

Primary endpoint: 1. Incidence of treatment-emergent adverse events (TEAEs) by indication., 2. Clinically significant changes in vital signs, clinical laboratory parameters, electrocardiogram by indication., 3. Incidence of adverse events of special interest (AESIs) by indication.
Endpoint(s): 1. Clinical remission by visit, assessed as proportion of participants achieving CD Activity Index (CDAI) <150., 2. Clinical response by visit, assessed as proportion of participants achieving reduction of CDAI from baseline (defined as baseline in parent phase 2 CD trial) of >100., 3. Endoscopic response at annual assessments at Week 48 and Week 108, assessed as proportion of participants achieving decrease in simplified endoscopic score for CD (SES-CD) >50% from baseline (defined as baseline in parent phase 2 CD trial) (or for participants with isolated ileal disease, SES-CD <4 or at least a 2-point from baseline read centrally)., 4. Endoscopic remission at annual assessments at Week 48 and Week 108, assessed as proportion of participants achieving SES-CD <4 or <2 for ileal disease., 5. Clinical remission in two patient-reported outcome items (PRO2) of the CDAI by visit, assessed as proportion of participants with average daily liquid or very soft stool frequency (SF) score ≤2.8 and not worse than baseline (defined as baseline in parent phase 2 CD trial) and average daily abdominal pain (AP) score ≤1 and not worse than baseline (defined as baseline in parent phase 2 CD trial)., 6. Clinical response in PRO2 by visit, assessed as proportion of participants with ≥30% decrease in average daily very soft or liquid stools and/ or ≥30% decrease in average AP from baseline (defined as baseline in parent phase 2 CD trial)., 1. Clinical remission at annual assessments (Week 48 and Week 108), assessed as proportion of participants achieving a modified Mayo Score (mMS) of ≤2 with SF subscore of ≤1, rectal bleeding subscore of 0, and centrally read endoscopic subscore of ≤1 (score of 1 modified to exclude friability)., 2. Clinical Response at annual assessments (Week 48 and Week 108), assessed as the proportion of participants achieving a reduction from baseline (defined as baseline in parent phase 2 UC trial) in mMS of ≥2 points and ≥30% from baseline (defined as baseline in parent phase 2 UC trial) and a decrease from baseline in the rectal bleeding subscore of ≥1 point or absolute rectal bleeding subscore of ≤1 point., 3. Symptomatic remission by visit, assessed as the proportion of participants achieving a rectal bleeding subscore of 0 and SF subscore of Mayo score of ≤1., 4. Endoscopic improvement at annual assessments (Week 48 and Week 108), assessed as the proportion of participants achieving a modified Mayo endoscopic subscore of ≤1 (score of 1 to exclude friability)., 5. Endoscopic remission at annual assessments (Week 48 and Week 108), assessed as the proportion of participants achieving a modified Mayo endoscopic subscore of 0., 1. Proportion of participants with no bowel urgency by visit as measured by the bowel urgency eDiary item., 2. Proportion of participants with no AP by visit as measured by the AP eDiary item., 3. Change from baseline (defined as baseline in parent phase 2 CD or UC trials) in fatigue as measured by the FACIT-Fatigue score by visit., 4. Disease-specific HRQoL as measured by the Inflammatory Bowel Disease Questionnaire (IBDQ) total score by visit, assessed as the proportion of participants with total score ≥170., 5. Change from baseline (defined as baseline in parent phase 2 CD or UC trials) in disease‑specific HRQoL by visit as measured by the IBDQ total score.

Source: https://euclinicaltrials.eu/ctis-public/view/2024-518914-18-00